EU clinical trial 2023-507939-38-00: A First-in-Human, randomised, double blind, placebo-controlled, single ascending dose trial to evaluate safety, tolerability, and pharmacokinetics of APC148 in healthy adults.
Protocol code: APC148-001
Sponsor: Adjutec Pharma AS (Pharmaceutical company). Phase: Human Pharmacology (Phase I)- First administration to humans. Countries: Sweden (ended).
Therapeutic area(s): Diseases [C] - Bacterial Infections and Mycoses [C01]
Gender: Female, Male. Age: 18-64 years. Enrolment: 46.
Status: Ended. Start date (EU): 2024-08-28. End date (EU): 2025-03-10. Decision date: 2024-05-06. Results received: No. Last updated: 2024-05-06.

Condition(s): Urinary tract infections (UTIs)/complicated UTI (cUTI)

Source: https://euclinicaltrials.eu/ctis-public/view/2023-507939-38-00